EU clinical trial 2024-513492-41-00: M9466 Alone or in Combination in Advanced Solid Tumors (DDRiver 501)
Protocol code: MS202659_0001
Sponsor: Merck Healthcare KGaA (Pharmaceutical company). Phase: Human Pharmacology (Phase I)- Other. Countries: Spain (ended).
Therapeutic area(s): Diseases [C] - Neoplasms [C04]
Gender: Female, Male. Age: 18-64 years, 65+ years. Enrolment: 50.
Status: Ended. Start date (EU): 2024-11-19. End date (EU): 2026-07-02. Decision date: 2024-09-10. Results received: No. Last updated: 2026-05-25.

Condition(s): Advanced solid tumors

Source: https://euclinicaltrials.eu/ctis-public/view/2024-513492-41-00